EU clinical trial 2024-515136-72-00: Short bowel syndrome and study of the absorption of antibiotics with good oral bioavailability
Protocol code: 2020PI028
Sponsor: CHRU De Nancy (Hospital/Clinic/Other health care facility). Phase: Therapeutic use (Phase IV). Countries: France (ongoing, recruiting).
Therapeutic area(s): Diseases [C] - Digestive System Diseases [C06]
Gender: Female, Male. Age: 18-64 years, 65+ years. Enrolment: 10.
Status: Ongoing, recruiting. Start date (EU): 2022-06-17. Decision date: 2024-09-03. Results received: No. Last updated: 2025-12-15.

Condition(s): Patient with short bowel syndrome treated with antibiotics for a bacterial infection

Source: https://euclinicaltrials.eu/ctis-public/view/2024-515136-72-00